EU clinical trial 2023-507428-21-00: Comparative Bioavailability of Diclofenac 2.32% Gel in Healthy Adult Subjects
Protocol code: b1-23-CIDg
Sponsor: Alkaloid AD Skopje (Pharmaceutical company). Phase: Human Pharmacology (Phase I)- Bioequivalence Study. Countries: Portugal (ended).
Therapeutic area(s): Not possible to specify
Gender: Female, Male. Age: 18-64 years. Enrolment: 50.
Status: Ended. End date (EU): 2024-12-17. Decision date: 2023-10-27. Results received: No. Last updated: 2024-02-07.

Condition(s): No medical condition.

Source: https://euclinicaltrials.eu/ctis-public/view/2023-507428-21-00